EU clinical trial 2025-522855-25-00: J4G-MC-JZVD - FORAGER-2: A Phase 3, Randomized, Double-blind, Placebo-controlled Study Evaluating the Efficacy and Safety of Vepugratinib Combined with Enfortumab Vedotin and Pembrolizumab in Adults with Untreated Locally Advanced or Metastatic Urothelial Carcinoma with an FGFR3 Genetic Alteration.
Protocol code: J4G-MC-JZVD
Sponsor: Eli Lilly & Co. (Pharmaceutical company). Phase: Therapeutic confirmatory (Phase III). Countries: Italy (authorised, recruitment pending), Poland (authorised, recruitment pending), Denmark (authorised, recruitment pending), Czechia (authorised, recruitment pending), France (authorised, recruiting), Hungary (authorised, recruitment pending), Germany (authorised, recruitment pending), Netherlands (authorised, recruitment pending), Spain (authorised, recruiting).
Therapeutic area(s): Diseases [C] - Neoplasms [C04]
Gender: Female, Male. Age: 18-64 years, 65+ years. Enrolment: 197.
Start date (EU): 2026-07-14. Decision date: 2026-04-20. Results received: No. Last updated: 2026-07-21.
Decision dates by country: CZ: 2026-04-21, DK: 2026-04-20, DE: 2026-04-23, HU: 2026-04-22, IT: 2026-04-23, NL: 2026-04-23, PL: 2026-04-23, FR: 2026-04-24, ES: 2026-04-24

Condition(s): Urinary Bladder Neoplasms, Neoplasm Metastasis, Carcinoma, Transitional Cell
Product: PEMBROLIZUMAB, Placebo to match ly, ENFORTUMAB VEDOTIN

Primary endpoint: Safety Lead-in:Safety and Tolerability of vepugratinib in combination with EV and pembrolizumab, Safety Lead-in:Overall Response Rate (ORR), Progression-free Survival (PFS) by Blinded Independent Central Review (BICR)

Source: https://euclinicaltrials.eu/ctis-public/view/2025-522855-25-00